EU clinical trial 2022-502678-18-00: Efficacy and safety of co-administered cagrilintide and semaglutide (CagriSema) s.c. in doses 2.4/2.4 mg and 1.0/1.0 mg once weekly versus semaglutide 2.4 mg and 1.0 mg, cagrilintide 2.4 mg and placebo in participants with type 2 diabetes inadequately controlled on metformin with or without an SGLT2 inhibitor
Protocol code: NN9388-4896
Sponsor: Novo Nordisk A/S (Pharmaceutical company). Phase: Therapeutic confirmatory (Phase III). Countries: Denmark (ended), Sweden (ended), Slovakia (ended), Hungary (ended), Poland (ended), Czechia (ended), Germany (ended), Finland (ended), Italy (ended), Spain (ended), Greece (ended), Croatia (ended), Slovenia (ended), Bulgaria (ended), Romania (ended).
Therapeutic area(s): Diseases [C] - Nutritional and Metabolic Diseases [C18]
Gender: Female, Male. Age: 18-64 years, 65+ years. Enrolment: 1223.
Status: Ended. Start date (EU): 2023-11-07. End date (EU): 2025-12-29. End date: 2026-01-06. Decision date: 2023-10-30. Results received: No. Last updated: 2026-01-28.
Decision dates by country: DE: 2023-11-03, ES: 2023-11-06, GR: 2023-11-03, PL: 2023-11-06, CZ: 2023-11-03, SK: 2023-11-03, IT: 2023-10-31, DK: 2023-10-30, HU: 2023-11-02, FI: 2023-11-03, BG: 2023-11-06, RO: 2023-11-06, HR: 2023-11-03, SI: 2023-11-03, SE: 2023-10-31

Condition(s): Type 2 diabetes
Product: semaglutide, cagrilintide semaglutide, cagrilintide semaglutide, Placebo + Placebo, cagrilintide, cagrilintide semaglutide, METFORMIN, DAPAGLIFLOZIN, cagrilintide, cagrilintide, semaglutide, cagrilintide, semaglutide, cagrilintide semaglutide, cagrilintide, semaglutide, cagrilintide semaglutide, semaglutide

Primary endpoint: Change in HbA1c from baseline (week 0) to end of treatment (week 68)
Endpoint(s): Superiority of CagriSema 00 mg/00 mg versus cagrilintide 00 mg: Change in HbA1c from baseline (week 0) to end of treatment (week 68), Superiority of CagriSema 00 mg/00 mg versus cagrilintide 00 mg: Relative change in body weight from baseline (week 0) to end of treatment (week 68), Superiority of CagriSema 00 mg/00 mg versus semaglutide 00 mg: Change in HbA1c from baseline (week 0) to end of treatment (week 68), Superiority of CagriSema 00 mg/00 mg versus semaglutide 00 mg: Relative change in body weight from baseline (week 0) to end of treatment (week 68), Superiority of cagrilintide 00 mg versus placebo: Change in HbA1c from baseline (week 0) to end of treatment (week 68), Superiority of cagrilintide 00 mg versus placebo: Relative change in body weight from baseline (week 0) to end of treatment (week 68), Superiority of CagriSema versus semaglutide (00 mg/00 mg versus 00 mg and 00 mg/00 mg vs 00 mg): Achievement of ≥ 10 % weight reduction from baseline (week 0) to end of treatment (week 68), Superiority of CagriSema versus semaglutide (00 mg/00 mg versus 00 mg and 00 mg/00 mg vs 00 mg): Achievement of ≥ 15 % weight reduction From baseline (week 0) to end of treatment (week 68), Superiority of CagriSema versus semaglutide (00 mg/00 mg versus 00 mg and 00 mg/00 mg vs 00 mg): Achievement of ≥ 20 % weight reduction From baseline (week 0) to end of treatment (week 68), Superiority of CagriSema versus semaglutide (00 mg/00 mg versus 00 mg and 00 mg/00 mg vs 00 mg, respectively): CGM: Change in time in tight target range (TITR) 3.9–7.8 mmol/L (70–140 mg/dL) From baseline (week -3 to end of treatment (week 68), Superiority of CagriSema versus semaglutide (00 mg/00 mg versus 00 mg and 00 mg/00 mg vs 00 mg, respectively): Change in systolic blood pressure (SBP) from baseline (week 0) to end of treatment (week 68), Superiority of CagriSema versus semaglutide (00 mg/00 mg versus 00 mg and 00 mg/00 mg vs 00 mg, respectively): Ratio to baseline in triglycerides from baseline (week 0) to end of treatment (week 68), Superiority of CagriSema versus semaglutide (00 mg/00 mg versus 00 mg and 00 mg/00 mg vs 00 mg, respectively): Ratio to baseline in non-HDL cholesterols from baseline (week 0) to end of treatment (week 68), Superiority of CagriSema versus semaglutide (00 mg/00 mg versus 00 mg and 00 mg/00 mg vs 00 mg, respectively): CGM: Change in time in range (TIR) 3.9–10.0 mmol/L (70–180 mg/dL) from baseline (week -3) to end of treatment (week 68), Superiority of CagriSema versus semaglutide (00 mg/00 mg versus 00 mg and 00 mg/00 mg vs 00 mg, respectively): Ratio to baseline in high sensitivity C-reactive protein (hsCRP) from baseline (week 0) to end of treatment (week 68), Effect of CagriSema versus semaglutide (00 mg/00 mg versus 00 mg and 00 mg/00 mg vs 00 mg, respectively): Change in Fasting Plasma Glucose (FPG) From baseline (week 0) to end of treatment (week 68), Effect of CagriSema versus semaglutide (00 mg/00 mg versus 00 mg and 00 mg/00 mg vs 00 mg, respectively): Achievement of HbA1c target values of <7.0% (<53 mmol/mol) at end of treatment (week 68), Effect of CagriSema versus semaglutide (00 mg/00 mg versus 00 mg and 00 mg/00 mg vs 00 mg, respectively): Achievement of HbA1c target values of ≤6.5% (≤48 mmol/mol) at end of treatment (week 68), Effect of CagriSema versus semaglutide (00 mg/00 mg versus 00 mg and 00 mg/00 mg vs 00 mg, respectively): CGM: Change in Time above range, >10.0 mmol/L (>180 mg/dL) from baseline (week -3) to end of treatment (week 68), Effect of CagriSema versus semaglutide (00 mg/00 mg versus 00 mg and 00 mg/00 mg vs 00 mg, respectively): CGM: Change in Time above range, >13.9 mmol/L (>250 mg/dL) from baseline (week -3) to end of treatment (week 68), Effect of CagriSema versus semaglutide (00 mg/00 mg versus 00 mg and 00 mg/00 mg vs 00 mg, respectively): CGM: Within-day glycaemic variability (% CV) at end of treatment (week 68), Effect of CagriSema versus semaglutide (00 mg/00 mg versus 00 mg and 00 mg/00 mg vs 00 mg, respectively): Achievement of ≥ 5 % weight reduction from baseline (week 0) to end of treatment (week 68), Effect of CagriSema versus semaglutide (00 mg/00 mg versus 00 mg and 00 mg/00 mg vs 00 mg, respectively): Change in waist circumference from baseline (week 0) to end of treatment (week 68), Effect of CagriSema versus semaglutide (00 mg/00 mg versus 00 mg and 00 mg/00 mg vs 00 mg, respectively): Change in diastolic blood pressure (DBP) from baseline (week 0) to end of treatment (week 68), Effect of CagriSema versus semaglutide (00 mg/00 mg versus 00 mg and 00 mg/00 mg vs 00 mg, respectively): Ratio to baseline in lipids: Total cholesterol, High-density lipoprotein (HDL) cholesterol, Low-density lipoprotein (LDL) cholesterol, Very low-density lipoprotein (VLDL) cholesterol, Free fatty acids from baseline (week 0) to end of treatment (week 68), Effect of CagriSema versus semaglutide (00 mg/00 mg versus 00 mg and 00 mg/00 mg vs 00 mg, respectively): Change in SF-36v2 score: Physical Component Summary score, Mental Component Summary score from baseline (week 0) to end of treatment (week 68), Effect of CagriSema versus semaglutide (00 mg/00 mg versus 00 mg and 00 mg/00 mg vs 00 mg, respectively): Change in Diabetes Treatment Satisfaction Questionnaire (DTSQ) score from baseline (week 0) to end of treatment (week 68), Effect of CagriSema versus semaglutide (00 mg/00 mg versus 00 mg and 00 mg/00 mg vs 00 mg, respectively): Change in Treatment Related Impact Measure for Diabetes (TRIM-D) score from baseline (week 0) to end of treatment (week 68), Safety and tolerability of CagriSema (00 mg/00 mg and 00 mg/00 mg) versus semaglutide (00 mg and 00 mg), placebo and cagrilintide 00 mg: Number of Treatment Emergent Adverse Events (TEAEs) from baseline (week 0) to end of study (week 75), Safety and tolerability of CagriSema (00 mg/00 mg and 00 mg/00 mg) versus semaglutide (00 mg and 00 mg), placebo and cagrilintide 00 mg: Number of clinically significant hypoglycaemic episodes (level 2) (<3.0 mmol/L (54 mg/dL), confirmed by BG meter) from baseline (week 0) to end of study (week 75), Safety and tolerability of CagriSema (00 mg/00 mg and 00 mg/00 mg) versus semaglutide (00 mg and 00 mg), placebo and cagrilintide 00 mg: Number of severe hypoglycaemic episodes (level 3): hypoglycaemia associated with severe cognitive impairment requiring external assistance for recovery, with no specific glucose threshold from baseline (week 0) to end of study (week 75), Superiority of CagriSema 00 mg/00 mg versus semaglutide 00 mg: Relative change in body weight from baseline (week 0) to end of treatment (week 68), Superiority of CagriSema 00 mg/00 mg versus semaglutide 00: Change in HbA1c, Superiority of CagriSema 00 mg/00 mg versus semaglutide 00 mg: Relative change in body weight, Superiority of CagriSema (pooled doses) versus semaglutide (pooled doses): CGM: Change in time in range (TIR) 3.9–10.0 mmol/L (70–180 mg/dL) from baseline (week -3) to end of treatment (week 68)

Source: https://euclinicaltrials.eu/ctis-public/view/2022-502678-18-00